EU clinical trial 2024-512151-21-00: A Phase 1, Open-Label Study to Investigate the TARP-ɣ8 Receptor Occupancy of RAP-219 Using a TARP-γ8 PET Tracer in Healthy Adult Participants
Protocol code: RAP-219-103
Sponsor: Rapport Therapeutics Inc. (Pharmaceutical company). Phase: Human Pharmacology (Phase I)- Other. Countries: Belgium (ended).
Therapeutic area(s): Diseases [C] - Nervous System Diseases [C10]
Gender: Female, Male. Age: 18-64 years. Enrolment: 24.
Status: Ended. Start date (EU): 2024-06-19. End date (EU): 2024-12-16. Decision date: 2024-05-27. Results received: No. Last updated: 2024-05-27.

Condition(s): Epilepsy

Source: https://euclinicaltrials.eu/ctis-public/view/2024-512151-21-00